EU clinical trial 2024-510605-28-00: A RANDOMIZED, DOUBLE-BLIND, PHASE 3 COMPARISON OF PLATINUM-BASED THERAPY WITH TSR-042 AND NIRAPARIB VERSUS STANDARD OF CARE PLATINUM-BASED THERAPY AS FIRST-LINE TREATMENT OF STAGE III OR IV NONMUCINOUS EPITHELIAL OVARIAN CANCER
Protocol code: 213350/3000-03-005
Sponsor: Tesaro Inc. (Pharmaceutical company). Phase: Therapeutic confirmatory (Phase III). Countries: Germany (ongoing, recruitment ended), Czechia (ended), Norway (ended), Finland (ended), France (ended), Spain (ended), Poland (ongoing, recruitment ended), Belgium (ended), Netherlands (ended), Denmark (ended), Romania (ongoing, recruitment ended), Italy (ended), Greece (ended).
Therapeutic area(s): Diseases [C] - Female Urogenital Diseases and Pregnancy Complications [C13]
Gender: Female. Age: 18-64 years, 65+ years. Enrolment: 947.
Start date (EU): 2018-11-27. Decision date: 2024-04-10. Results received: No. Last updated: 2026-07-20.
Decision dates by country: CZ: 2024-04-10, NO: 2024-04-22, NL: 2024-04-10, IT: 2024-04-11, ES: 2024-04-10, BE: 2024-04-17, FR: 2024-04-15, DK: 2024-04-10, PL: 2024-04-24, GR: 2024-05-22, DE: 2024-04-15, FI: 2024-04-10, RO: 2024-04-11

Condition(s): Stage 3 or 4 Non-mucinous Epithelial Ovarian Cancer
Product: Placebo is identical to the active drugs but without the active drug substance to maintain study blinding. Niraparib placebo tablets, Dostarlimab placebo infusion bags, JEMPERLI 500 mg concentrate for solution for infusion

Primary endpoint: The primary efficacy endpoint PFS is defined as the time from the date of randomization to the date of first documentation of progression or death by any cause, whichever occurs first
Endpoint(s): 1. Overall survival (OS), 2. BICR determined PFS per RECIST v1.1 criteria, 3. The absolute scores and change from baseline in the EQ-5D-5L Visual Analogue Score (VAS) and Health Utility Index (HUI) HRQoL assessments, 4. The absolute scores and change from baseline in the EORTC QLQ C30, and EORTC QLQ OV28 HRQoL assessments, 5. TFST, defined as the time from the date of randomization to the start date of the first subsequent anticancer therapy or death by any cause, whichever occurs first, 6. TSST, defined as the time from the date of randomization to the start date of the second subsequent anticancer therapy or death by any cause, whichever occurs first treatment or death by any cause (PFS2), 7. PFS2, defined as the time from the date of randomization to the date of first PD per Investigator’s assessment after initiation of subsequent anticancer therapy or death by any cause, whichever occurs first, 8. ORR, defined as the proportion of participants with a complete response (CR) or partial response (PR) per RECIST v1.1 by Investigator assessment, for participants with measurable disease at baseline, 9. DOR, defined as the time from first documentation of CR or PR until the time of first documentation of PD per RECIST v1.1 criteria by Investigator assessment, or death by any cause, whichever occurs first for participants with measurable disease at baseline, 10. DCR, defined as the proportion of participants with a best overall response of CR, PR, or stable disease (SD), per RECIST v1.1 by Investigator assessment, for participants with measurable disease at baseline

Source: https://euclinicaltrials.eu/ctis-public/view/2024-510605-28-00